EU clinical trial 2023-507981-17-00: Colchicine for ischemia with no obstructive coronary artery disease and microvascular dysfunction
Protocol code: 2023-507981-17-00
Sponsor: Region Hovedstaden (Hospital/Clinic/Other health care facility). Phase: Therapeutic exploratory (Phase II). Countries: Denmark (ongoing, recruiting).
Therapeutic area(s): Diseases [C] - Cardiovascular Diseases [C14]
Gender: Female, Male. Age: 18-64 years, 65+ years. Enrolment: 100.
Status: Ongoing, recruiting. Start date (EU): 2024-11-20. Decision date: 2023-12-19. Results received: No. Last updated: 2026-03-26.

Condition(s): CMD
Product: REGADENOSON, PLACEBO, ADENOSINE, Colchicine 500 microgram Tablets

Primary endpoint: Change in myocardial bloodflow reserve assessed by [15O]H2O-PET-scan from baseline and after 6 months
Endpoint(s): Change in Symptom burden assessed by Seattle Angina Questionnaire at baseline and 6 months, Identifying certain protein pathways and functional mechanisms in arteries associated with colchicine treatment., Changes in vascular function and protein pathway analyses in subsamples, Change in MBF assessed by [15O]H2O-PET-scan from baseline and after 6 months, Change in hMBF assessed by [15O]H2O-PET-scan from baseline and after 6 months

Source: https://euclinicaltrials.eu/ctis-public/view/2023-507981-17-00